EU clinical trial 2024-513174-22-00: A Phase 2 Multicenter, Randomized, Double-masked, Sham-controlled, Reference-arm Study to Evaluate Efficacy and Safety of ONL1204 in Patients With Geographic Atrophy (GA) Associated With Age-related Macular Degeneration (AMD)
Protocol code: ONL1204-GA-002
Sponsor: ONL Therapeutics Inc. (Laboratory/Research/Testing facility). Phase: Therapeutic exploratory (Phase II). Countries: Czechia (ongoing, recruiting), Hungary (ongoing, recruiting), Germany (authorised, recruiting), Austria (authorised, recruiting), Italy (ended), Spain (ongoing, recruiting), Poland (authorised, recruiting), Greece (ongoing, recruiting), Portugal (authorised, recruiting).
Therapeutic area(s): Diseases [C] - Eye Diseases [C11]; Phenomena and Processes [G] - Ocular Physiological Phenomena [G14]
Gender: Female, Male. Age: 18-64 years, 65+ years. Enrolment: 182.
Start date (EU): 2026-04-14. Decision date: 2025-08-05. Results received: No. Last updated: 2026-03-30.
Decision dates by country: ES: 2025-08-08, PT: 2025-08-06, DE: 2025-08-05, GR: 2025-08-11, PL: 2025-08-11, AT: 2025-08-11, IT: 2025-08-06, HU: 2025-08-07, CZ: 2025-08-06

Condition(s): Atrophic Age-related Macular Degeneration (AMD)
Product: ONL1204 Ophthalmic Solution, Sham injection

Primary endpoint: GA lesion area assessment

Source: https://euclinicaltrials.eu/ctis-public/view/2024-513174-22-00